EU clinical trial 2026-525604-99-00: First-in-human study to assess the safety and feasibility of intra-articular administration of allogeneic engineered gingival fibroblasts (aeGF) in participants with knee osteoarthritis.
Protocol code: GF-OA-001
Sponsor: Scarcell Therapeutics (Pharmaceutical company). Phase: Human Pharmacology (Phase I)- First administration to humans. Countries: Denmark (authorised, recruitment pending).
Therapeutic area(s): Diseases [C] - Musculoskeletal Diseases [C05]
Gender: Female, Male. Age: 18-64 years, 65+ years. Enrolment: 10.
Status: Authorised, recruitment pending. Decision date: 2026-05-26. Results received: No. Last updated: 2026-05-26.

Condition(s): Knee osteoarthritis

Source: https://euclinicaltrials.eu/ctis-public/view/2026-525604-99-00